EU clinical trial 2023-507802-15-00: A Single-Dose, Randomized, Open-Label, Crossover, Exploratory Bioavailability Study in Healthy Volunteers of Two Formulations of Gliclazide MR Tablets 120 mg (I.R.I.S.) and Two Diamicron® MR Tablets 60 mg (I.R.I.S.) under Fasting and Fed Conditions and Oral Solution of 60 mg Gliclazide (I.R.I.S.) under Fasting Conditions.
Protocol code: S005190-170
Sponsor: Institut De Recherches Internationales Servier IRIS (Pharmaceutical company). Phase: Human Pharmacology (Phase I)- Other. Countries: Portugal (ended).
Therapeutic area(s): Diseases [C] - Nutritional and Metabolic Diseases [C18]
Gender: Female, Male. Age: 18-64 years. Enrolment: 68.
Status: Ended. Start date (EU): 2023-11-07. End date (EU): 2023-12-20. Decision date: 2023-11-03. Results received: Yes. Last updated: 2023-11-03.

Condition(s): Type 2 diabetes mellitus
Product: Gliclazide 60mg/60ml oral solution, DIAMICRON 60MG, comprimé sécable à libération modifiée, Gliclazide modified release (MR) 120 mg tablets Test A1 (fast release rate), Gliclazide modified release (MR) 120 mg tablets Test A2 (medium release rate), Gliclazide modified release (MR) 120 mg tablets Test A3 (slow release rate), GLUCOSE, Gliclazide modified release (MR) 120 mg tablets Test B1 (fast release rate), GLUCOSE, Gliclazide modified release (MR) 120 mg tablets Test B2 (medium release rate), Gliclazide modified release (MR) 120 mg tablets Test B3 (slow release rate)

Primary endpoint: Cmax, AUC0-t and AUC0-∞ of Gliclazide will be the primary pharmacokinetic parameters.
Endpoint(s): tmax, tlag, Clast, tlast, t1/2, %AUCextrap and λz of Gliclazide will be the secondary pharmacokinetic parameters., Safety will be evaluated through the assessment of adverse events (AEs), laboratory tests, vital signs, physical examination, and electrocardiogram (ECG).

Source: https://euclinicaltrials.eu/ctis-public/view/2023-507802-15-00